EU clinical trial 2022-500273-14-00: A Phase 2b/3, Multicenter, Randomized, Double-Blind, Placebo-Controlled, Combined Dose-Finding and Cardiovascular Outcome Study to Investigate the Efficacy and Safety of CSL300 (Clazakizumab) in Subjects with End Stage Kidney Disease Undergoing Dialysis
Protocol code: CSL300_2301
Sponsor: CSL Behring LLC (Pharmaceutical company). Phase: Phase II and Phase III (Integrated). Countries: Hungary (ongoing, recruiting), Germany (ongoing, recruiting), Sweden (ongoing, recruiting), Belgium (ongoing, recruiting), Austria (ongoing, recruiting), Bulgaria (ongoing, recruiting), Croatia (ended), Denmark (ongoing, recruiting), Estonia (ended), France (ongoing, recruiting), Greece (ongoing, recruiting), Italy (ongoing, recruiting), Latvia (ended), Lithuania (ended), Portugal (ongoing, recruiting), Romania (ongoing, recruiting), Spain (ongoing, recruiting), Norway (ongoing, recruiting), Poland (ongoing, recruiting), Slovakia (ongoing, recruiting), Netherlands (authorised, recruitment pending), Czechia (ongoing, recruiting).
Therapeutic area(s): Diseases [C] - Cardiovascular Diseases [C14]
Gender: Female, Male. Age: 18-64 years, 65+ years. Enrolment: 1223.
Start date (EU): 2023-07-17. Decision date: 2023-04-20. Results received: No. Last updated: 2026-03-10.
Decision dates by country: HR: 2024-02-08, EE: 2024-01-11, LV: 2024-02-12, LT: 2024-02-02, BE: 2023-04-20, HU: 2023-04-24, AT: 2024-02-05, PL: 2024-02-02, BG: 2024-02-05, SK: 2024-02-09, DK: 2024-02-05, RO: 2023-12-18, CZ: 2025-09-24, ES: 2024-02-05, NO: 2024-02-02, IT: 2024-02-02, SE: 2023-04-24, NL: 2025-09-29, GR: 2024-02-05, DE: 2023-04-24, FR: 2024-02-01, PT: 2024-01-25

Condition(s): Atherosclerotic cardiovascular disease in patients with ESKD
Product: Saline Solution (0.9% w/v NaCl), Clazakizumab, CSL300 Placebo - matching the excipient content and concentration of the CSL300 product, minus the active ingredient, Clazakizumab

Primary endpoint: Change from Baseline on the log scale in hs-CRP (Phase 2b)., Time to first occurrence of CV death or myocardial infarction (MI) (Phase 3).
Endpoint(s): Percent of subjects achieving hs‑CRP less than (<) 2.0 milligram per Liter (mg/L) (Phase 2b)., Change from baseline in log-transformed hs‑CRP (Phase 2b)., Mean change from Baseline in serum amyloid A (SAA), secretory phospholipase A2 (sPLA2), fibrinogen, plasminogen activator inhibitor -1 (PAI-1), lipoprotein (a) [Lp (a)] and albumin (Phase 2b), Mean change from Baseline in Hepcidin, hemoglobin, erythropoiesis stimulating agent (ESA), erythropoietin resistance index (ERI), iron, total iron-binding capacity (TIBC), transferrin saturation (TSAT), ferritin (Phase 2b), Area under the plasma concentration versus time curve (AUC), peak plasma concentration (Cmax), trough plasma concentration (Ctrough), and time to maximum plasma concentration (Tmax) (Phase 2b), Percent of subjects with adverse event (AE), serious AE (SAE), including AEs of special interest (AESIs) (Phase 2b), Mean change from Baseline in white blood cell (WBC), neutrophil, platelets, aspartate aminotransferase (AST), alanine aminotransferase (ALT), total bilirubin; lipid panel: total cholesterol (TC), low-density lipoprotein cholesterol (LDL-C), high-density lipoprotein cholesterol (HDL-C), triglyceride, and Immunogenicity (Phase 2b), Time to first occurrence of all-cause death or MI (Phase 3)., Time to first occurrence of CV death, MI, or ischemic stroke (Phase 3)., Time to first occurrence of CV death (Phase 3)., Time to first occurrence of CV death, MI or major adverse limb event (Phase 3)., Time to first occurrence of all-cause death (Phase 3)., Time to first occurrence of CV death, MI, or hospitalization for heart failure (HF) (Phase 3)., Total number of CV hospitalizations (Phase 3)., Total number of HF hospitalizations and urgent visits (Phase 3)., Total number of hospitalizations (Phase 3).

Source: https://euclinicaltrials.eu/ctis-public/view/2022-500273-14-00